EU clinical trial 2023-504566-28-00: A Phase 2, Open-Label Study to Assess the Safety and Efficacy of Bemnifosbuvir (BEM) and Ruzasvir (RZR) in Subjects with Chronic Hepatitis C Virus (HCV) Infection
Protocol code: AT-01B-004
Sponsor: Atea Pharmaceuticals Inc. (Pharmaceutical company). Phase: Therapeutic exploratory (Phase II). Countries: Romania (ended), Germany (ended), Spain (ended).
Therapeutic area(s): Diseases [C] - Virus Diseases [C02]
Gender: Female, Male. Age: 18-64 years, 65+ years. Enrolment: 39.
Status: Ended. Start date (EU): 2023-05-19. End date (EU): 2025-01-28. End date: 2025-01-29. Decision date: 2023-07-26. Results received: Yes. Last updated: 2024-04-22.
Decision dates by country: RO: 2023-07-26, DE: 2024-04-03, ES: 2024-04-22

Condition(s): Chronic Hepatitis C Virus (HCV) Infection
Product: Ruzasvir, Bemnifosbuvir Hemisulfate

Primary endpoint: The primary efficacy endpoint is SVR12. The proportion of subjects achieving SVR12 with two-sided 95% CIs using the Wilson score method will be presented. Reasons for failure to achieve SVR12 will be summarized.
Endpoint(s): The proportion of subjects in the PP population experiencing virological failure (either on-treatment or post-treatment relapse by 12 weeks post treatment) will be estimated and presented with 95% CIs., The proportion of subjects in the PP population achieving SVR24 will be analyzed using the same method as SVR12.

Source: https://euclinicaltrials.eu/ctis-public/view/2023-504566-28-00